EU clinical trial 2022-503071-28-00: A Phase 3 Study to Evaluate Zimberelimab (AB122) Combined with Domvanalimab (AB154) Compared to Pembrolizumab in Front-Line, PD-L1-High, Locally Advanced or Metastatic Non-Small Cell Lung Cancer
Protocol code: ARC-10
Sponsor: Arcus Biosciences Inc. (Pharmaceutical company). Phase: Therapeutic confirmatory (Phase III). Countries: Ireland (ended), Spain (ended), France (ended), Greece (ended).
Therapeutic area(s): Diseases [C] - Neoplasms [C04]
Gender: Female, Male. Age: 18-64 years, 65+ years. Enrolment: 106.
Status: Ended. Start date (EU): 2023-08-31. End date (EU): 2025-01-10. Decision date: 2023-11-22. Results received: No. Last updated: 2024-07-10.
Decision dates by country: IE: 2023-11-22, ES: 2023-11-22, GR: 2024-01-22, FR: 2023-11-27

Condition(s): Squamous Non-small cell Lung Cancer, Non-Small Cell Lung Cancer, Non squamous Non Small Cell Lung Cancer, Lung Cancer
Product: KEYTRUDA 25 mg/mL concentrate for solution for infusion, DOMVANALIMAB, AB122 (Zimberelimab)

Primary endpoint: Overall survival (OS)
Endpoint(s): PFS according to RECIST v1.1 by blinded independent central review, and confirmed ORR according to RECIST v1.1 as assessed by BICR., Presence of treatment-emergent adverse events, and Changes in vital signs measurements and clinical laboratory parameters, Time to first symptom deterioration in NSCLC-SAQ total score

Source: https://euclinicaltrials.eu/ctis-public/view/2022-503071-28-00